EU clinical trial 2023-504188-18-00: Evaluation of the efficacy of micronized natural progesterone (Seidigestan®) vs GnRH antagonists (Astarté®) in the prevention of LH surge during controlled ovarian stimulation: a randomized clinical trial.
Protocol code: IBMR43
Sponsor: Instituto Bernabeu S.L. (Hospital/Clinic/Other health care facility). Phase: Therapeutic use (Phase IV). Countries: Spain (ongoing, recruiting).
Therapeutic area(s): Diseases [C] - Female Urogenital Diseases and Pregnancy Complications [C13]
Gender: Female. Age: 18-64 years. Enrolment: 150.
Status: Ongoing, recruiting. Start date (EU): 2023-11-08. Decision date: 2023-05-09. Results received: No. Last updated: 2023-05-09.

Condition(s): Women undergoing ovarian stimulation for oocyte donation.
Product: Bemfola 150 IU/0.25 mL solution for injection in pre-filled pen, Decapeptyl diario 0,1 mg polvo y disolvente para solución inyectable, Bemfola 225 IU/0.375 mL solution for injection in pre-filled pen, Ovaleap 300 IU/0.5 mL solution for injection, Astarté 0,25 mg/0,5 ml solución inyectable en jeringa precargada EFG, Seidigestan 200 mg cápsulas blandas

Primary endpoint: Number of oocytes obtained at metaphase II (MII) stage.
Endpoint(s): Number of cumulus-oocyte complexes (CCO) obtained., Number of germinal vesicles (VG)., Number of metaphase I (MI)., Number of oocytes suitable for insemination or microinjection.

Source: https://euclinicaltrials.eu/ctis-public/view/2023-504188-18-00